EU clinical trial 2023-507684-19-00: Phase 3, Randomized Study Evaluating the Efficacy and Safety of TAR-210 Erdafitinib Intravesical Delivery System Versus Single Agent Intravesical Chemotherapy in Participants With Intermediate-risk Non-muscle Invasive Bladder Cancer (IR-NMIBC) and Susceptible FGFR Alterations
Protocol code: 42756493BLC3004
Sponsor: Janssen Cilag International (Pharmaceutical company). Phase: Therapeutic confirmatory (Phase III). Countries: Spain (ongoing, recruiting), Denmark (ongoing, recruiting), France (ongoing, recruiting), Austria (ongoing, recruiting), Ireland (ongoing, recruitment ended), Belgium (ongoing, recruiting), Poland (ongoing, recruiting), Italy (ongoing, recruiting), Czechia (ongoing, recruiting), Germany (ongoing, recruiting).
Therapeutic area(s): Diseases [C] - Neoplasms [C04]
Gender: Female, Male. Age: 18-64 years, 65+ years. Enrolment: 201.
Start date (EU): 2024-07-24. Decision date: 2024-06-11. Results received: No. Last updated: 2026-05-27.
Decision dates by country: ES: 2024-06-11, CZ: 2024-06-12, PL: 2024-06-14, BE: 2024-06-13, IT: 2024-06-14, IE: 2024-06-14, AT: 2024-06-17, FR: 2024-06-12, DE: 2024-06-12, DK: 2024-06-12

Condition(s): FGFR+ Intermediate-risk Non-muscle Invasive Bladder Cancer
Product: JNJ-42756493, MITOMYCIN, GEMCITABINE

Primary endpoint: DFS will be measured as the time from randomization to the date of the first documented recurrence of NMIBC of any grade, disease progression, or death due to any cause, whichever occurs first

Source: https://euclinicaltrials.eu/ctis-public/view/2023-507684-19-00